EU clinical trial 2024-516489-12-00: An open label, balanced, randomized, two-treatment, two-period, two-sequence, single dose crossover bioequivalence study comparing Bosutinib Tablets 100 mg, Manufactured by Sun Pharmaceutical Industries Limited, India with Bosulif (bosutinib) 100 mg, Manufactured and Packed by: Pfizer Manufacturing Deutschland GmbH Betriebsstätte Freiburg Mooswaldallee, Freiburg, Germany, Imported by: Pfizer Brasil Ltda. Rodovia Presidente Castelo Branco, nº32501, km 32.5 CEP 06696-000 – Itapevi – SP, in healthy adult, human subjects under fed condition.
Protocol code: BOSUT-09-24
Sponsor: Sun Pharmaceutical Industries Limited (Pharmaceutical company). Phase: Human Pharmacology (Phase I)- Bioequivalence Study. Countries: Romania (ended).
Therapeutic area(s): Diseases [C] - Neoplasms [C04]
Gender: Female, Male. Age: 18-64 years. Enrolment: 72.
Status: Ended. Start date (EU): 2025-01-31. End date (EU): 2025-04-30. Decision date: 2024-12-16. Results received: No. Last updated: 2024-12-16.

Condition(s): myeloid leukemia

Source: https://euclinicaltrials.eu/ctis-public/view/2024-516489-12-00